EU clinical trial 2025-520694-39-00: GRACIE : Phase II study evaluating ivonescimab in combination with chemotherapy for first- and second-line treatment of advanced or metastatic gastric and gastroesophageal adenocarcinoma patients
Protocol code: UC-GIG-2411
Sponsor: Unicancer (Hospital/Clinic/Other health care facility). Phase: Therapeutic exploratory (Phase II). Countries: France (ongoing, recruiting).
Therapeutic area(s): Diseases [C] - Neoplasms [C04]
Gender: Female, Male. Age: 18-64 years, 65+ years. Enrolment: 88.
Status: Ongoing, recruiting. Start date (EU): 2025-10-24. Decision date: 2025-09-08. Results received: No. Last updated: 2026-04-03.

Condition(s): Metastatic or locally advanced irresectable (stage IV) gastric cancer (GC) or esophagogastric junction cancer (EGJC), with and without actionable biomarker (HER2/Claudin18.2)
Product: IRINOTECAN, CALCIUM LEVOFOLINATE, ivonescimab, FOLINIC ACID, OXALIPLATIN, PACLITAXEL, FLUOROURACIL

Primary endpoint: ORR defined as the proportion of patients achieving complete response (CR) or partial response (PR) as assessed by central review according to RECIST v1.1. Patients with unevaluable or unknown response status will be considered as non-responders.
Endpoint(s): ORR defined as the proportion of patients achieving complete response (CR) or partial response (PR) as assessed by the investigator according to RECIST v1.1. Patients with unevaluable or unknown response status will be considered as non-responders., Duration of response, defined as the time from first documented PR or CR (compared to baseline measurement taken at screening) until the date of PD, as assessed by the investigator and centralized review according to RECIST v1.1, or death from any cause, whichever occurs first. Patients who are alive and have not progressed at the time of the analysis will be censored at their last evaluable tumor assessment., PFS, defined as the time from inclusion to the first documented progression of disease (PD) as assessed by the investigator and centralized review according to RECIST v1.1, or death from any cause, whichever occurs first. Patients who are alive and have not progressed at the time of the analysis will be censored at their last evaluable tumor assessment., OS, defined as the time from inclusion to death due to any cause. Patients still alive at the cut-off date (including those lost to follow-up) will be censored at the last date at which they are known to be alive., Time to deterioration of ECOG performance status, defined as the time from inclusion to the first observation of ECOG performance status ≥2., Toxicity / Adverse events (AEs), occurrence of treatment-related AEs, treatment-related AEs (TRAEs) leading to dose reduction or discontinuation during treatment, serious adverse events (SAEs) and suspected unexpected serious adverse reactions (SUSARs), immune-related AEs (irAEs) graded according to NCI-CTCAE V5.0, HRQoL assessed using the European Organisation for Research and Treatment of Cancer (EORTC) quality of life questionnaires QLQ-C30 and QLQ- OG25

Source: https://euclinicaltrials.eu/ctis-public/view/2025-520694-39-00